EU clinical trial 2024-511616-24-00: The goal of this clinical study is to learn more about the safety and dosing of the study drugs, KITE-363 and KITE-753, in participants with relapsed and/or refractory B-cell lymphoma.
Protocol code: KT-US-499-0150
Sponsor: Kite Pharma Inc. (Pharmaceutical company). Phase: Human Pharmacology (Phase I)- First administration to humans. Countries: Germany (ongoing, recruitment ended), Netherlands (ongoing, recruiting).
Therapeutic area(s): Diseases [C] - Neoplasms [C04]
Gender: Female, Male. Age: 18-64 years, 65+ years. Enrolment: 21.
Start date (EU): 2024-12-06. Decision date: 2024-05-29. Results received: No. Last updated: 2026-08-03.
Decision dates by country: NL: 2024-05-29, DE: 2024-06-10

Condition(s): Relapsed and/or Refractory B-cell Lymphoma

Source: https://euclinicaltrials.eu/ctis-public/view/2024-511616-24-00